EU clinical trial 2024-513376-17-00: Phase II study of adjuvant pressurized intraperitoneal aerosol chemotherapy (PIPAC) for the prevention of peritoneal metastases after curative-intent surgery for high-risk colorectal cancer.
Sponsor: Fondazione IRCCS Istituto Nazionale Dei Tumori (Hospital/Clinic/Other health care facility). Phase: Therapeutic exploratory (Phase II). Countries: Italy (ongoing, recruiting).
Therapeutic area(s): Diseases [C] - Neoplasms [C04]
Gender: Female, Male. Age: 18-64 years, 65+ years. Enrolment: 30.
Status: Ongoing, recruiting. Start date (EU): 2020-11-24. Decision date: 2024-06-18. Results received: No. Last updated: 2024-06-18.

Condition(s): colorectal cancer
Product: Fluorouracile AHCL 50 mg/ml, Soluzione per iniezione o infusione, Oxaliplatino Accord 5 mg/ml concentrato per soluzione per infusione, LEVOFOLENE 175 mg polvere per soluzione per infusione

Primary endpoint: The efficacy of adjuvant PIPAC will be assessed by measuring peritoneal metastasis-free survival from the date of primary surgery to the date of MP diagnosis.

Source: https://euclinicaltrials.eu/ctis-public/view/2024-513376-17-00